EU clinical trial 2025-521658-40-00: A first-in-human, open-label, dose finding study to evaluate the safety, tolerability and pharmacokinetics of EGL-003 in healthy volunteers followed by adults with autoimmune disease.
Protocol code: EGL-311
Sponsor: Egle Therapeutics (Pharmaceutical company). Phase: Human Pharmacology (Phase I)- First administration to humans. Countries: Germany (ongoing, recruiting), Bulgaria (authorised, recruitment pending), Poland (authorised, recruitment pending).
Therapeutic area(s): Diseases [C] - Skin and Connective Tissue Diseases [C17]
Gender: Female, Male. Age: 18-64 years. Enrolment: 58.
Start date (EU): 2025-10-27. Decision date: 2025-10-01. Results received: No. Last updated: 2026-02-02.
Decision dates by country: BG: 2025-10-06, PL: 2025-10-06, DE: 2025-10-01

Condition(s): Atopic dermatitis

Source: https://euclinicaltrials.eu/ctis-public/view/2025-521658-40-00